EU clinical trial 2024-518747-38-00: A Phase 2 Randomized, Double-blind, Placebo-controlled, Dose-Finding Study to Evaluate the Safety, Tolerability, Preliminary Efficacy and Pharmacokinetics of iN1011-N17-02 in Patients with Post herpetic Neuralgia (PHN)
Protocol code: iN1011-N17201
Sponsor: iN Therapeutics Co. Ltd. (Pharmaceutical company). Phase: Therapeutic exploratory (Phase II). Countries: Poland (ended), Bulgaria (ended).
Therapeutic area(s): Diseases [C] - Nervous System Diseases [C10]
Gender: Female, Male. Age: 18-64 years, 65+ years. Enrolment: 66.
Status: Ended. End date (EU): 2025-09-01. Decision date: 2025-07-09. Results received: No. Last updated: 2025-07-14.
Decision dates by country: BG: 2025-07-09, PL: 2025-07-14

Condition(s): Post herpetic Neuralgia
Product: PARACETAMOL, Placebo for iN1011-N17-02, Doreta, 37,5 mg + 325 mg, tabletki powlekane

Primary endpoint: The mean change from Baseline to the last week of treatment (Week 4) in the average weekly numeric rating scale (NRS) pain score
Endpoint(s): Incidence, severity, and causality of adverse events (AEs) and serious AEs (SAEs), Abnormalities in the following: o Physical examination o Vital signs (pulse rate, systolic/diastolic blood pressure, respiratory rate, and tympanic temperature) o 12-lead electrocardiogram (ECG) o Laboratory tests (hematology, urinalysis, and serum chemistry), Daily pain intensity assessed by NRS pain score, Score of Short Form McGill Pain Questionnaire (SF-MPQ-2, Score of Brief Pain Inventory-Short Form (BPI-SF), Change in average weekly NRS pain score from Baseline to Weeks 1, 2, and 3, Change from Baseline over time in individual parameters assessed using SF MPQ-2, The percentage of responders defined as participants with a ≥ 30% and ≥ 50% reduction in their NRS pain score from Baseline to Week 4, Percentage of participants with much improved or very much improved change in pain according to Clinical Global Impression of Change (CGIC) and Patient Global Impression of Change (PGIC) at Week 4, Change from Baseline to Week 4 in Pain Quality Assessment Scale (PQAS) score, Rescue medication consumption (dose, frequency, Change from Baseline to Week 4 in BPI-SF score, pain interference subscale, Change from Baseline to Week 4 in Daily Sleep Interference Scale (DSIS), The following PK parameters will be evaluated at Day 1 (pre-dose and post-dose after single dose, 0 3 hours): o Maximum plasma concentration (Cmax) o Time to maximum plasma concentration (Tmax) o Area under the plasma concentration curve over the twice daily (bid) dosing interval (AUC0-3), The following PK urine parameters will be evaluated on Day 1 (0 3 hours): o Fraction excreted unchanged in urine, from time 0 to 3 hours (fe,0-3) o Amount of investigational product (IP) excreted unchanged in the urine, from time 0 to 3 hours (Ae,0-3) o Renal clearance (CLR), The following PK parameters will be evaluated at steady state at Week 4 on the last day of dosing: oPlasma IP concentration pre-dose (C0) oMaximum steady-state plasma IP concentration during a dosage interval (Cmax,ss) oMinimum steady-state plasma IP concentration during a dosage interval (Cmin) oTime to reach maximum (peak) plasma concentration following IP administration at steady-state (Tmax,ss) oArea under the plasma concentration-time curve, from time 0 (pre-dose) to 3 hours postdose(AUC0-3, The following urine PK parameters will be evaluated at steady-state at Week 4 on the last day of dosing: o Fe0-3,ss o Ae0-3,ss o CLR

Source: https://euclinicaltrials.eu/ctis-public/view/2024-518747-38-00